EU clinical trial 2023-504829-39-00: COBEX-PED Corticosteroids before extubation in pediatric intensive care unit: a prospective randomized double-blind multicenter study
Protocol code: APHP220674
Sponsor: Assistance Publique Hopitaux De Paris (Hospital/Clinic/Other health care facility). Phase: Therapeutic confirmatory (Phase III). Countries: France (ongoing, recruiting).
Therapeutic area(s): Diseases [C] - Respiratory Tract Diseases [C08]
Gender: Female, Male. Age: 0-17 years. Enrolment: 348.
Status: Ongoing, recruiting. Start date (EU): 2025-10-28. Decision date: 2024-10-25. Results received: No. Last updated: 2026-01-23.

Condition(s): respiratory distress due to upper airway obstruction in child
Product: DEXAMETHASONE PHOSPHATE, Placebo of dexamethasone

Primary endpoint: Cumulative incidence of DRPE/OVAS within 48 hours post-extubation
Endpoint(s): Cumulative incidence of reintubation due to DRPE/OVAS within 48 hours of planned extubation, Odds-Ratios associated with the occurrence of DRPE/OVAS ratio within 48 hours post-extubation, Number of days of hospitalization in URP, Calculation of the number of days free of ventilatory assistance in URP, Calculation of the number of days with non-invasive ventilation post-extubation, Incidence of side effects of DXM-IV occurring from randomization to 48 hours post-extubation.

Source: https://euclinicaltrials.eu/ctis-public/view/2023-504829-39-00